EU clinical trial 2024-519494-19-00: A randomized, double-blind, Phase 3 study to investigate efficacy and safety of teplizumab compared with placebo in participants 1 to 25 years of age with recently diagnosed Stage 3 Type 1 Diabetes (T1D) (βETA PRESERVE)
Protocol code: EFC18241
Sponsor: Sanofi-Aventis Recherche & Developpement (Pharmaceutical company). Phase: Therapeutic confirmatory (Phase III). Countries: Czechia (ongoing, recruiting), Netherlands (ongoing, recruiting), Italy (ongoing, recruiting), Germany (ongoing, recruiting), Belgium (ongoing, recruiting), France (ongoing, recruiting), Poland (ongoing, recruiting), Spain (ongoing, recruiting), Greece (ongoing, recruiting), Romania (authorised, recruitment pending).
Therapeutic area(s): Diseases [C] - Nutritional and Metabolic Diseases [C18]
Gender: Female, Male. Age: 0-17 years, 18-64 years. Enrolment: 504.
Start date (EU): 2025-12-22. Decision date: 2025-05-04. Results received: No. Last updated: 2026-07-14.
Decision dates by country: NL: 2025-11-25, GR: 2026-04-29, RO: 2025-05-04, PL: 2025-11-30, BE: 2025-11-26, IT: 2025-11-26, FR: 2026-02-18, ES: 2026-02-16, CZ: 2025-11-25, DE: 2026-02-17

Condition(s): Nutritional and metabolic diseases
Product: Teplizumab, Matched placebo for test product

Primary endpoint: For United States (US) and non-European Union (EU) countries: Glycated hemoglobin (HbA1c) change from baseline, For US and non-EU countries: Total number of days without prandial insulin use, For EU countries: Change from baseline in mean 2 hours mixed meal tolerance test (MMTT) stimulated C-peptide concentration, calculated from Area Under the Curve (AUC) in participants 5 years and older, For EU countries: HbA1c change from baseline, For EU countries: Total number of days without prandial insulin use
Endpoint(s): Change from baseline in mean 2 hours MMTT stimulated C-peptide concentration, calculated from AUC, Participants remaining C-peptide positive (2 hours MMTT stimulated peak C-peptide concentration ≥0.2 nmol/L), Incidence of participants with HbA1c ≤6.5% and requiring ≤0.25 IU/kg/day of insulin, Change from baseline in Time-in-Range (TIR) (70-180 mg/dL blood glucose) assessed by continuous glucose monitoring (CGM), Number of level 2 and 3 (according to American Diabetes Association) hypoglycemic events per participant year (event rates), Number of participants with treatment emergent adverse events (TEAEs), serious adverse events (SAEs), adverse events of special interest (AESIs) and TEAEs leading to treatment discontinuation, Teplizumab PK parameters: Maximum concentration of teplizumab [Cmax], Teplizumab PK parameters: Area under the curve [AUC] and [AUClast], Incidence of antidrug-antibodies (ADAs)

Source: https://euclinicaltrials.eu/ctis-public/view/2024-519494-19-00